EU clinical trial 2025-520652-28-00: An Experimental Medicine multicenter Trial to evaluate the safety and immunogenicity of experimental versus authorized SARS-CoV-2 vaccine candidates as a booster dose in healthy participants previously vaccinated with authorized mRNA SARS-CoV-2 vaccines.
Protocol code: ANRS0711s SOLVE-01
Sponsor: ANRS Maladies Infectieuses Emergentes (Laboratory/Research/Testing facility). Phase: Human Pharmacology (Phase I)- First administration to humans. Countries: France (ongoing, recruiting).
Therapeutic area(s): Diseases [C] - Pathological Conditions, Signs and Symptoms [C23]; Diseases [C] - Virus Diseases [C02]
Gender: Female, Male. Age: 18-64 years, 65+ years. Enrolment: 32.
Status: Ongoing, recruiting. Start date (EU): 2026-05-04. Decision date: 2026-01-21. Results received: No. Last updated: 2026-02-19.
Decision dates by country: FR: 2026-02-19

Condition(s): healthy participants

Source: https://euclinicaltrials.eu/ctis-public/view/2025-520652-28-00